EU clinical trial 2024-516777-77-00: Phase II Study of Avelumab plus chemotherapy in the peri-operative treatment for patients with resectable Gastric cancer (GC) or Gastroesophageal Junction cancer (GEJC). Moneo trial
Protocol code: VHIO19001
Sponsor: Vall D Hebron Institute Of Oncology (Laboratory/Research/Testing facility). Phase: Therapeutic exploratory (Phase II). Countries: Spain (ongoing, recruiting).
Therapeutic area(s): Diseases [C] - Neoplasms [C04]
Gender: Female, Male. Age: 18-64 years, 65+ years. Enrolment: 30.
Status: Ongoing, recruiting. Start date (EU): 2024-10-31. Decision date: 2024-10-31. Results received: No. Last updated: 2024-10-31.

Condition(s): Resectable Gastric cancer (GC) or Gastroesophageal Junction cancer (GEJC)
Product: DOCETAXEL, AVELUMAB, FLUOROURACIL, OXALIPLATIN, CALCIUM FOLINATE

Primary endpoint: Pathological complete response (pCR) rate, where pCR is defined as the absence of residual tumor based on evaluation of the resected esophagogastric specimen according to Becker remission criteria [1].
Endpoint(s): Overall survival (OS) [time frame: from the initial date of neoadjuvant chemotherapy to the date of death due to any cause. Patients without documentation of death at the time of analysis will be censored at the last follow-up date]. Estimated using Kaplan-Meier method., Disease-free survival (DFS) [time frame: from the surgery to the first observation of disease relapse or death due to any cause. Patients without an event prior to the time of analysis will be censored at the last relapse-free assessment]. Relapse is defined according to RECIST v1.1. Estimated using Kaplan- Meier method., Progression-free survival (PFS) [time frame: from the initial date of neoadjuvant chemotherapy to the date of first documentation of disease progression or death due to any cause, whichever occurs first. Patients without an event prior to the time of analysis will be censored at the last assessment that is stable disease (SD) or better]. Progression is defined according to RECIST v1.1. Estimated using Kaplan-Meier method., Surgical complete resection rate (R0). This is a complete macroscopic resection of the gross tumor with negative surgical margins, Overall Response rate (ORR) to neoadjuvancy, as the proportion of subjects with complete response (CR)and partial response (PR), according to RECIST v1.1. [time frame: from the initial date of neoadjuvant chemotherapy to 3 years post- treatment)., Safety endpoints: safety of the combination of avelumab with FLOT chemotherapy (docetaxel, oxaliplatin and fluorouracil/leucovorin) Exploratory Endpoints • Pathological immune response (pIR) • Characterization of the immune contexture • Immunodynamic follow-up • TCR clonality assessment

Source: https://euclinicaltrials.eu/ctis-public/view/2024-516777-77-00